EU clinical trial 2024-510690-16-00: SYMPHONY-1: A PHASE 1B/3 DOUBLE-BLIND, RANDOMIZED, ACTIVE-CONTROLLED, 3-STAGE, BIOMARKER ADAPTIVE STUDY OF TAZEMETOSTAT OR PLACEBO IN COMBINATION WITH LENALIDOMIDE PLUS RITUXIMAB IN SUBJECTS WITH RELAPSED/REFRACTORY FOLLICULAR LYMPHOMA
Protocol code: EZH-302
Sponsor: Epizyme Inc. (Pharmaceutical company). Phase: Therapeutic confirmatory (Phase III). Countries: Hungary (ongoing, recruiting), Belgium (ended), Poland (ongoing, recruiting), France (ongoing, recruiting), Germany (ongoing, recruiting), Italy (ongoing, recruiting), Spain (ongoing, recruiting).
Therapeutic area(s): Diseases [C] - Hemic and Lymphatic Diseases [C15]
Gender: Female, Male. Age: 18-64 years, 65+ years. Enrolment: 226.
Start date (EU): 2022-01-31. Decision date: 2024-08-12. Results received: No. Last updated: 2026-02-22.
Decision dates by country: BE: 2024-08-12, HU: 2024-08-14, FR: 2024-08-29, DE: 2024-08-13, IT: 2024-08-19, PL: 2024-08-13, ES: 2024-08-13

Condition(s): Relapsed/refractory follicular lymphoma
Product: MabThera 100 mg concentrate for solution for infusion, Lenalidomide Mylan 2.5 mg hard capsules, Lenalidomide Mylan 15 mg hard capsules, Lenalidomide Mylan 2.5 mg hard capsules, Lenalidomide ratiopharm 15 mg, harde capsules, Lenalidomide ratiopharm 2,5 mg, harde capsules, Lenalidomide Mylan 20 mg hard capsules, Revlimid 10 mg hard capsules, Lenalidomide Mylan 15 mg hard capsules, Placebo not identical to IMP, major ingredients: microcrystalline cellulose, starch, magnesium stearate, opadry red or yellow, Lenalidomide ratiopharm 20 mg, harde capsules, MabThera 500 mg concentrate for solution for infusion, Revlimid 2.5 mg hard capsules, Lenalidomide Mylan 20 mg hard capsules, Truxima 500 mg concentrate for solution for infusion, Lenalidomide Mylan 5 mg hard capsules, Revlimid 20 mg hard capsules, Revlimid 5 mg hard capsules, Lenalidomide Mylan 10 mg hard capsules, Lenalidomide Mylan 5 mg hard capsules, Revlimid 15 mg hard capsules, Lenalidomide ratiopharm 5 mg, harde capsules, Lenalidomide ratiopharm 10 mg, harde capsules, Lenalidomide Mylan 10 mg hard capsules, Truxima 100 mg concentrate for solution for infusion

Primary endpoint: Recommended Phase 3 Dose (RP3D) of tazemetostat in combination with rituximab and lenalidomide (R2) The safety and tolerability of tazemetostat in combination with R2 in subjects with R/R FL will be evaluated. RP3D of tazemetostat for further evaluation in phase 3 will be selected as assessed by the occurrence of treatment-emergent dose-limiting toxicities (DLTs) and adverse events (AEs)., Progression-Free Survival (PFS) in the Intent-to-treat wild-type (ITT-WT) population PFS is defined as the time from the date of randomization to the time of confirmed disease progression per the 2014 Lugano Classification or death, whichever occurs first, as assessed by Investigators., PFS in the Intent-to-treat mutant-type (ITT-MT) population PFS is defined as the time from the date of randomization to the time of confirmed disease progression per the 2014 Lugano Classification or death, whichever occurs first, as assessed by Investigators.
Endpoint(s): Phase 1: Pharmacokinetics (PK) of tazemetostat: Maximum (peak) Observed Plasma Drug Concentration (Cmax). Cmax will be recorded from the PK blood samples collected., Phase 1: PK of tazemetostat, EPZ 6930 (desethyl metabolite), and lenalidomide as data permit: Time to Maximum Observed Drug Concentration (Tmax), Phase 1: PK of tazemetostat: area under the plasma concentration-time curve (AUC) from time 0 to the time of the last quantifiable concentration [AUC(0-t)], Phase 1: PK of tazemetostat: area under the plasma concentration-time curve (AUC) from time 0 to infinity [AUC(0-∞)], Phase 1: The apparent terminal elimination half-life (t1/2) of tazemetostat, EPZ 6930 (desethyl metabolite), and lenalidomide as data permit, Complete Response Rate (CRR) in ITT-WT population CRR is defined as the proportion of participants achieving CR according to the 2014 Lugano Classification, as assessed by the Investigator and a blinded Independent Review Committee (IRC)., CRR in ITT-MT population CRR is defined as the proportion of participants achieving CR according to the 2014 Lugano Classification, as assessed by the Investigator and a blinded IRC, CRR in the Relapsed/Refractory (R/R) Follicular Lymphoma (FL) population regardless of mutation status CRR is defined as the proportion of participants achieving CR according to the 2014 Lugano Classification, as assessed by the Investigator and a blinded IRC., Objective Response Rate (ORR) in the ITT-WT population ORR is defined as the proportion of participants achieving a best overall response (BOR) of partial response (PR) or complete response (CR) according to the 2014 Lugano Classification, as assessed by the Investigator and a blinded IRC., ORR in the ITT-MT population ORR is defined as the proportion of participants achieving a best overall response (BOR) of partial response (PR) or complete response (CR) according to the 2014 Lugano Classification, as assessed by the Investigator and a blinded IRC., ORR in the R/R FL population regardless of mutation status ORR is defined as the proportion of participants achieving a best overall response (BOR) of partial response (PR) or complete response (CR) according to the 2014 Lugano Classification, as assessed by the Investigator and a blinded IRC, Overall Survival (OS) in the ITT-WT population OS is defined as the time from the date of randomization until death due to any cause., OS in the ITT-MT populatio, OS in the R/R FL population regardless of mutation status, PFS in the ITT-WT population, assessed by a blinded IRC, PFS in the ITT-MT population, assessed by a blinded IRC, PFS in the R/R FL population regardless of mutation status, assessed by a blinded IRC, PFS in the R/R FL population regardless of mutation status, assessed by the Investigator, Duration Of Response (DOR) in the ITT-WT population DOR is defined as the time from initial CR or PR to documented progression or death due to any cause, whichever occurs first, for those participants with a CR or PR, as assessed by the Investigator and by a blinded IRC, DOR in the ITT-MT population DOR is defined as the time from initial CR or PR to documented progression or death due to any cause, whichever occurs first, for those participants with a CR or PR, as assessed by the Investigator and by a blinded IRC, DOR in the R/R FL population regardless of mutation status DOR is defined as the time from initial CR or PR to documented progression or death due to any cause, whicheve, Duration Of Complete Response (DOCR) in the ITT-WT population DOCR is defined as the time from initial CR to documented progression or death due to any cause, whichever occurs first, for those participants with CR, assessed by the Investigator and by a blinded IRC., DOCR in the ITT-MT population DOCR is defined as the time from initial CR to documented progression or death due to any cause, whichever occurs first, for those participants with CR, assessed by the Investigator and by a blinded IRC., DOCR in the R/R FL population regardless of mutation status DOCR is defined as the time from initial CR to documented progression or death due to any cause, whichever occurs first, for those participants with CR, assessed by the Investigator and by a blinded IRC., Disease Control Rate (DCR) in the ITT-WT population DCR, defined as the proportion of participants with best overall response of CR, PR, or stable disease (SD) lasting 12 or more months, as assessed by the Investigator and by a blinded IRC., DCR in the ITT-MT population DCR, defined as the proportion of participants with best overall response of CR, PR, or stable disease (SD) lasting 12 or more months, as assessed by the Investigator and by a blinded IRC., DCR in the R/R FL population regardless of mutation status DCR, defined as the proportion of participants with best overall response of CR, PR, or stable disease (SD) lasting 12 or more months, as assessed by the Investigator and by a blinded IRC., Population PK parameters of oral clearance (CL/F) of tazemetostat, Population PK parameters of oral volume of distribution (Vd/F) of tazemetostat., Population PK parameters of first-order absorption rate constant (Ka) for tazemetostat., Percentage of Participants Experiencing Adverse Events (AEs) An Adverse event (AE) is any untoward medical occurrence in a clinical study participant, temporally associated with the use of study intervention, whether or not considered related to the study intervention., Percentage of Participants with Clinically Significant Changes in Physical Examination Percentage of participants with clinically significant changes in physical examination findings will be reported. The clinical significance will be graded by the investigator according to the National Cancer Institute Common Terminology Criteria for AEs (CTCAE) Version 5.0., Percentage of Participants with Clinically Significant Changes in Vital Signs Percentage of participants with clinically significant changes in vital signs findings will be reported. The clinical significance will be graded by the investigator according to the National Cancer Institute Common Terminology Criteria for AEs (CTCAE) Version 5.0., Percentage of Participants with Clinically Significant Changes in Electrocardiogram (ECG) Readings Percentage of participants with clinically significant changes in ECG Readings will be reported. The clinical significance will be graded by the investigator according to the National Cancer Institute Common Terminology Criteria for AEs (CTCAE) Version 5.0., Performance status evaluated by Eastern Cooperation Oncology Group (ECOG) ECOG is a 6-point performance status scale used to assess performance using PA as a key indicator (e.g., 0 = fully active, 2 = up and about more than 50% of walking hours, 5 = dead) Performance status will be assessed per usual clinical practice and will be recorded in the medical record., Duration of Study Drug Exposure Duration of exposure to study drug will be reported, Percentage of study drug taken by participants, Quality of life questionnaires evaluation Evaluate and compare health-related quality of life as measured by the EuroQOL 5-Dimension 5-Level (EQ-5D-5L) instrument and the Functional Assessment of Cancer Therapy –Lymphoma (FACT-Lym)

Source: https://euclinicaltrials.eu/ctis-public/view/2024-510690-16-00